EU clinical trial 2023-508162-15-00: A Phase III, Randomised, Double-blind Study to Evaluate the Effect of Balcinrenone/Dapagliflozin, Compared with Dapagliflozin, on the Risk of Heart Failure Events and Cardiovascular Death in Patients with Heart Failure and Impaired Kidney Function
Protocol code: D6402C00012
Sponsor: AstraZeneca AB (Pharmaceutical company). Phase: Therapeutic confirmatory (Phase III). Countries: Slovakia (ongoing, recruiting), Spain (ongoing, recruiting), Finland (ongoing, recruiting), Greece (ongoing, recruiting), Austria (ongoing, recruiting), Romania (ongoing, recruiting), Germany (ongoing, recruiting), Poland (ongoing, recruiting), Italy (ongoing, recruiting), Hungary (ongoing, recruiting), Netherlands (ongoing, recruiting), France (ongoing, recruiting), Sweden (ongoing, recruiting), Bulgaria (ongoing, recruiting), Czechia (ongoing, recruiting).
Therapeutic area(s): Diseases [C] - Cardiovascular Diseases [C14]
Gender: Female, Male. Age: 18-64 years, 65+ years. Enrolment: 1194.
Status: Ongoing, recruiting. Start date (EU): 2024-07-12. Decision date: 2024-06-18. Results received: No. Last updated: 2026-04-27.
Decision dates by country: HU: 2024-06-21, FI: 2024-06-18, IT: 2024-06-20, GR: 2024-06-21, NL: 2024-07-25, ES: 2024-06-18, SE: 2024-06-19, RO: 2024-06-25, FR: 2024-06-20, PL: 2024-09-04, AT: 2024-06-24, DE: 2024-06-21, CZ: 2024-08-21, SK: 2024-06-18, BG: 2024-06-24

Condition(s): Chronic HF and comorbid impairment of kidney function who had a recent HF event to evaluate the effect of balcinrenone/dapagliflozin versus dapagliflozin alone on HF events and cardiovascular (CV) death
Product: Balcinrenone+Dapagliflozin, Balcinrenone+Dapagliflozin, Forxiga, Balcinrenone+Dapagliflozin, Forxiga 10 mg film-coated tablets

Primary endpoint: Time to first occurrence of any of the components of the composite of: • CV death • HF hospitalisation • HF event without hospitalisation
Endpoint(s): 1. Total occurrences (first and recurrent) of the components of the composite of: • CV death • HF hospitalisation • HF event without hospitalisation, 2. Total occurrences (first and recurrent) of HF hospitalisations, 3. Time to CV death, 4. The hierarchical composite endpoint of death from any cause, total HF events, and change from baseline in KCCQ total symptom score to 24-week post-randomisation, 5.Time to death from any cause

Source: https://euclinicaltrials.eu/ctis-public/view/2023-508162-15-00